EU clinical trial 2023-509912-27-00: A Phase 3 Study to Evaluate the Efficacy and Safety of Pegozafermin in Subjects with Metabolic Dysfunction-Associated Steatohepatitis (MASH) and Fibrosis
Protocol code: BIO89-100-131
Sponsor: 89bio Inc. (Pharmaceutical company). Phase: Therapeutic confirmatory (Phase III). Countries: Spain (ongoing, recruiting), Poland (ongoing, recruiting), France (ongoing, recruiting), Italy (ongoing, recruiting), Bulgaria (ongoing, recruiting), Belgium (ongoing, recruiting), Germany (ongoing, recruiting), Netherlands (ongoing, recruiting), Czechia (ongoing, recruiting), Austria (authorised, recruitment pending).
Therapeutic area(s): Diseases [C] - Nutritional and Metabolic Diseases [C18]
Gender: Female, Male. Age: 18-64 years, 65+ years. Enrolment: 260.
Start date (EU): 2024-11-07. Decision date: 2024-07-30. Results received: No. Last updated: 2026-08-07.
Decision dates by country: FR: 2024-11-14, ES: 2024-07-29, PL: 2024-08-04, AT: 2025-09-29, BG: 2024-08-05, IT: 2024-07-30, CZ: 2025-09-15, BE: 2024-07-30, NL: 2024-08-05, DE: 2024-07-31

Condition(s): Metabolic Dysfunction-Associated Steatotic Liver Disease(MASH) / Nonalcoholic Steatohepatitis (NASH) With Fibrosis
Product: Placebo for pegozafermin. combined integral administration device: pre-filled syringe - please refer to the IMPD pegozafermin section 3.2.p.7 container closure system for detailed description., Pegozafermin

Primary endpoint: 1_Proportion of participants achieving the co-primary endpoints measured at 52 weeks of: _ Improvement in fibrosis by ≥1 stage without worsening of steatohepatitis -resolution of steatohepatitis without worsening of fibrosis
Endpoint(s): 1_Change From Baseline in Liver Fat as Assessed by Magnetic Resonance Imaging - Proton Density Fat Fraction (MRI-PDFF) at Week 52, 2_Percent Change from Baseline in Alanine Aminotransferase (ALT) at Week 52 and Month 36, 3_Time to First Occurrence of Disease Progression as Measured by Composite of Protocol -Specified Clinical Events Up to Month 36, 4_Absolute change from baseline in ELF score at 52 weeks

Source: https://euclinicaltrials.eu/ctis-public/view/2023-509912-27-00